EU clinical trial 2022-500339-35-01: Exploratory study evaluating the relevance of [68Ga]Ga-PentixaFor for initial staging and detection of minimal residual disease in multiple myeloma patients eligible for autologous stem cell transplantation less than 66 years included in the prospective IFM 2020-02.
Protocol code: RC22_0150
Sponsor: Centre Hospitalier Universitaire De Nantes (Hospital/Clinic/Other health care facility). Phase: Therapeutic exploratory (Phase II). Countries: France (ended).
Therapeutic area(s): Analytical, Diagnostic and Therapeutic Techniques and Equipment [E] - Diagnosis [E01]
Gender: Female, Male. Age: 18-64 years, 65+ years. Enrolment: 45.
Status: Ended. End date (EU): 2023-05-23. Decision date: 2022-12-14. Results received: Yes. Last updated: 2023-03-13.

Condition(s): Multiple Myeloma
Product: EPINEPHRINE, [68Ga]Ga-PentixaFor, PARACETAMOL, FLUDEOXYGLUCOSE (18F)

Primary endpoint: Sensitivity will be assessed by patient and lesion analysis by defining: • True positive (TP): - positive lesion with [68Ga]Ga-PentixaFor-PET and confirmed by another imaging method (FDG-PET/CT, CT scan or MRI) and follow-up or confirmed by histology. • False negative (FN): - negative lesion with [68Ga]Ga-PentixaFor-PET and positive by FDG-PET and confirmed by CT scan/ MRI or histology, or confirmed by follow-up
Endpoint(s): The specificity (PPV and NPV) of [68Ga]Ga-PentixaFor-PET at the time of initial diagnosis will be assessed by patient and lesion analysis using the same definitions of TP and FN as for the primary objective at the time of initial diagnosis, The prognostic impact of FDG-PET and [68Ga]Ga-PentixaFor-PET based on the number of lesions detected and their intensity of uptake by each imaging technique will be evaluated by assessing the impact of these data on the PFS and OS at the time of initial diagnosis. PFS is defined as the time from the start of treatment to relapse or progression. OS is defined as the time from the start of first treatment to death, We will consider as discordant a lesion positive by FDG-PET but negative by [68Ga]Ga-PentixaFor-PET and/or a lesion negative by FDG-PET but positive by [68Ga]Ga-PentixaFor-PET at the time of initial diagnosis, [68Ga]Ga-PentixaFor and FDG uptakes assessed by SUV and the quantitative expression of biological markers on myelogram (including expression of the gene coding for hexokinases) at the time of initial diagnosis, Tolerance of [68Ga]Ga-PentixaFor will be assessed by clinical monitoring of the patient for 1 hour after [68Ga]Ga-PentixaFor injection. Clinical data (heart rate, oxygen saturation and blood pressure) will be collected prior and 5/10 min after [68Ga]Ga-PentixaFor injection before acquisition (at 60 min after the injection) and at the end of acquisition (at approximately 80 min after the injection) at the time of initial diagnosis, We will consider as discordant a lesion positive by FDG-PET but negative by [68Ga]Ga-PentixaFor-PET and/or a lesion negative by FDG-PET but positive by [68Ga]Ga-PentixaFor-PET after induction therapy, The prognostic impact of [68Ga]Ga-PentixaFor-PET after therapy will be determined by evaluating the impact of a decrease uptake and/or a normalization of images on PFS and OS after induction therapy, FDG-PET and [68Ga]Ga-PentixaFor-PET results (positive/negative) and minimal residual disease evaluated by NGS (positive/negative) after induction therapy, Tolerance of [68Ga]Ga-PentixaFor will be assessed by clinical monitoring of the patient for 1 hour after [68Ga]Ga-PentixaFor injection. Clinical data (heart rate, oxygen saturation and blood pressure) will be collected prior and 5/10 min after [68Ga]Ga-PentixaFor injection before acquisition (at 60 min after the injection) and at the end of acquisition (at approximately 80 min after the injection) after induction therapy, SUV collected during the examination, FDG-PET and [68Ga]Ga-PentixaFor-PET results (positive/negative).

Source: https://euclinicaltrials.eu/ctis-public/view/2022-500339-35-01